EU clinical trial 2024-518746-24-00: Does the glucagon-like peptide-1 receptor agonist semaglutide prevent deterioration of metabolic state in prediabetic or diabetic patients with schizophrenia treated with the antipsychotic compounds clozapine or olanzapine?
Sponsor: Psykiatrisk Center Kobenhavn (Hospital/Clinic/Other health care facility). Phase: Therapeutic exploratory (Phase II). Countries: Denmark (ended).
Therapeutic area(s): Psychiatry and Psychology [F] - Mental Disorders [F03]
Gender: Female, Male. Age: 18-64 years. Enrolment: 104.
Status: Ended. End date (EU): 2026-02-25. Decision date: 2024-11-04. Results received: Yes. Last updated: 2024-11-04.

Condition(s): Schizophrenia
Product: Ozempic 1 mg solution for injection in pre-filled pen, Placebo for semaglutide, CompCart 1.5 ml, PDS290

Primary endpoint: The primary endpoint is the change from baseline in glycated haemoglobin A1c (HbA1c)
Endpoint(s): Changes in body weight, hip, waist circumference, blood pressure, heart rate, plasma insulin, C-peptide, glucagon, incretin hormones, lipid profile, proteomics and bone markers, insulin sensitivity, beta-cell function (evaluated by HOMA. Body composition and bone density evaluated by DXA-scan), liver function (transaminases), liver fibrosis (fibrosis-4 (FIB-4) score), alcohol, tobacco and drug use, preference for sweet and fatty candy, psychopathology, activity and quality of life.

Source: https://euclinicaltrials.eu/ctis-public/view/2024-518746-24-00